EU clinical trial 2023-505122-34-00: A Phase 3 Multicenter, Randomized, Double-blind, Placebo-controlled Study to Evaluate the Efficacy and Safety of JNJ-77242113 for the Treatment of Participants with Plaque Psoriasis involving Special Areas
Protocol code: 77242113PSO3003
Sponsor: Janssen - Cilag International (Pharmaceutical company). Phase: Therapeutic confirmatory (Phase III). Countries: Spain (ongoing, recruitment ended), Germany (ongoing, recruitment ended), Poland (ongoing, recruitment ended), Hungary (ongoing, recruitment ended).
Therapeutic area(s): Diseases [C] - Immune System Diseases [C20]
Gender: Female, Male. Age: 0-17 years, 18-64 years, 65+ years. Enrolment: 146.
Status: Ongoing, recruitment ended. Start date (EU): 2023-12-05. Decision date: 2023-11-27. Results received: No. Last updated: 2026-03-23.
Decision dates by country: PL: 2023-11-30, HU: 2023-12-04, ES: 2023-12-01, DE: 2023-11-28

Condition(s): Plaque Psoriasis
Product: Film-Coated Tablet without JNJ-77242113, JNJ-77242113

Primary endpoint: IGA (overall) score of 0 or 1 and a ≥2-grade improvement from baseline at Week 16.

Source: https://euclinicaltrials.eu/ctis-public/view/2023-505122-34-00